EU clinical trial 2023-507294-18-00: A Phase III Randomized, Open-label Study to Evaluate Efficacy and Safety of Pembrolizumab (MK-3475) in Combination with Axitinib versus Sunitinib Monotherapy as a First-line Treatment for Locally Advanced or Metastatic Renal Cell Carcinoma (mRCC) (KEYNOTE-426)
Protocol code: MK-3475-426
Sponsor: Merck Sharp & Dohme LLC (Pharmaceutical company). Phase: Therapeutic confirmatory (Phase III). Countries: Ireland (ended), Hungary (ended), Czechia (ended), Germany (ended), Spain (ended), France (ended), Poland (ended).
Therapeutic area(s): Diseases [C] - Neoplasms [C04]
Gender: Female, Male. Age: 18-64 years, 65+ years. Enrolment: 269.
Status: Ended. Start date (EU): 2016-09-16. End date (EU): 2025-09-11. End date: 2025-12-26. Decision date: 2023-12-14. Results received: No. Last updated: 2025-09-10.
Decision dates by country: IE: 2023-12-14, FR: 2024-02-02, DE: 2023-12-21, CZ: 2023-12-15, HU: 2023-12-14, ES: 2023-12-22, PL: 2024-06-10

Condition(s): Metastatic renal cell carcinoma
Product: KEYTRUDA 25 mg/mL concentrate for solution for infusion, SUNITINIB, AXITINIB

Primary endpoint: Progression-Free Survival (PFS) Per Response Evaluation Criteria in Solid Tumors Version 1.1 (RECIST 1.1) as Assessed by Blinded Independent Central Imaging Review, Overall Survival (OS)
Endpoint(s): Objective Response Rate (ORR) Per Response Evaluation Criteria in Solid Tumors Version 1.1 (RECIST 1.1) as Assessed by Blinded Independent Central Imaging Review, Disease Control Rate (DCR) Per Response Evaluation Criteria in Solid Tumors Version 1.1 (RECIST 1.1) as Assessed by Blinded Independent Central Imaging Review, Duration of Response (DOR) Per Response Evaluation Criteria in Solid Tumors Version 1.1 (RECIST 1.1) as Assessed by Blinded Independent Central Imaging Review, Number of Participants Who Experienced an Adverse Event (AE), Number of Participants Who Discontinued Study Drug Due to an AE, Progression Free Survival Rate (PFS Rate) at Month 12 in All Participants, Progression Free Survival Rate (PFS Rate) at Month 18 in All Participants, Progression Free Survival Rate (PFS Rate) at Month 24 in All Participants, Overall Survival (OS) Rate at Month 12 in All Participants, Overall Survival (OS) Rate at Month 18 in All Participants, Overall Survival (OS) Rate at Month 24 in All Participants, Time to True Deterioration (TTD) of the Functional Assessment of Cancer Therapy Kidney Symptom Index Disease-Related Symptoms (FKSI-DRS) Score, Least Squares (LS) Mean Change From Baseline to Week 54 in the European Organization for Research and Treatment of Cancer Quality of Life Questionnaire-Core 30 (EORTC QLQ-C30) Global Health Status (GHS) Scale Score

Source: https://euclinicaltrials.eu/ctis-public/view/2023-507294-18-00